EU clinical trial 2025-522705-37-00: B7981119 A Phase 2, Multicenter, Randomized, Double-Blind, Placebo-Controlled, 16-Week Study Evaluating the Safety and Efficacy of Ritlecitinib (PF-06651600) in Adults with Moderate to Severe Hidradenitis Suppurativa
Protocol code: B7981119
Sponsor: Pfizer Inc. (Pharmaceutical company). Phase: Therapeutic exploratory (Phase II). Countries: Germany (ongoing, recruitment ended), Poland (ongoing, recruitment ended), Spain (ongoing, recruitment ended), Greece (ongoing, recruitment ended).
Therapeutic area(s): Diseases [C] - Skin and Connective Tissue Diseases [C17]
Gender: Female, Male. Age: 18-64 years, 65+ years. Enrolment: 71.
Status: Ongoing, recruitment ended. Start date (EU): 2026-04-21. Decision date: 2026-03-11. Results received: No. Last updated: 2026-06-10.
Decision dates by country: PL: 2026-03-27, ES: 2026-04-02, DE: 2026-03-11, GR: 2026-03-12

Condition(s): HIDRADENITIS SUPPURATIVA
Product: Placebo for pf-06651600-15, Ritlecitinib Tosilate

Primary endpoint: HiSCR50 response at Week 16
Endpoint(s): HiSCR50 response at Weeks 1, 2, 4, 6, 8, and Week 12., HiSCR75 response at Weeks 1, 2, 4, 6, 8, 12 and Week 16., HiSCR90 response at Weeks 1, 2, 4, 6, 8, 12 and Week 16., Response based on a total abscess and nodule (AN) count of 0 or 1 at Week 16., Response based on a total AN count of 0, 1, or 2 at Week 16., Percent (%) change from baseline (CFB) in total AN count at Weeks 1, 2, 4, 6, 8, 12 and 16., Absolute score and CFB in HS-IGA at Weeks 1, 2, 4, 6, 8, 12 and 16., Response based on achieving a HS-IGA=0 or 1 at Weeks 1, 2, 4, 6, 8, 12 and 16., Participants who experience an HS flare, defined as at least a 25% increase in total AN count with a minimum increase of 2 relative to Baseline, at Weeks 4, 8, 12 and 16., CFB in Hidradenitis Suppurativa Symptom Daily Diary (HSSDD) at Weeks 1, 2, 4, 6, 8, 12 and 16., Skin pain NRS30 response, at worst and on average, respectively, at Weeks 1, 2, 4, 6, 8, 12, and 16, among participants with baseline skin pain numeric rating scale (NRS) ≥3., %CFB in skin pain NRS, at worst and on average, respectively, in participants with baseline skin pain NRS ≥3, at Weeks 1, 2, 4, 6, 8, 12, and 16., CFB in skin pain NRS, at worst and on average, respectively, at Weeks 1, 2, 4, 6, 8, 12, and 16., Skin pain NRS50 response, at worst and on average, respectively, at Weeks 1, 2, 4, 6, 8, 12, and 16, among participants with baseline skin pain NRS ≥3., Skin pain NRS70 response, at worst and on average, respectively, at Weeks 1, 2, 4, 6, 8, 12, and 16, among participants with baseline skin pain NRS ≥3., Incidence of treatment emergent adverse events (TEAEs), serious adverse events (SAEs) and adverse events (AEs) leading to discontinuation, Incidence of clinically significant laboratory abnormalities over time, Absolute score and CFB in Hidradenitis Suppurativa Quality of Life (HiSQOL) at Weeks 1, 2, 4, 6, 8, 12 and 16., Absolute score and % CFB in IHS4 at Weeks 1, 2, 4, 6, 8, 12 and 16.

Source: https://euclinicaltrials.eu/ctis-public/view/2025-522705-37-00